EU clinical trial 2023-503673-38-00: A Double-blind, Randomized, Placebo-controlled, Multicenter Study to Evaluate the Impact of Evolocumab on Major Cardiovascular Events in Patients at High Cardiovascular Risk Without Prior Myocardial Infarction or Stroke
Protocol code: 20170625
Sponsor: Amgen Inc. (Pharmaceutical company). Phase: Therapeutic confirmatory (Phase III). Countries: Latvia (ended), Italy (ended), Estonia (ended), Czechia (ended), Finland (ended), Netherlands (ended), Hungary (ended), Sweden (ended), France (ended), Portugal (ended), Romania (ended), Lithuania (ended), Iceland (ended), Spain (ended), Poland (ended), Germany (ended), Belgium (ended), Bulgaria (ended), Austria (ended), Greece (ended), Denmark (ended), Slovakia (ended).
Therapeutic area(s): Diseases [C] - Nutritional and Metabolic Diseases [C18]
Gender: Female, Male. Age: 18-64 years, 65+ years. Enrolment: 6020.
Status: Ended. Start date (EU): 2019-05-24. End date (EU): 2025-07-16. End date: 2025-07-25. Decision date: 2024-04-08. Results received: Yes. Last updated: 2025-11-14.
Decision dates by country: BG: 2024-04-08, GR: 2024-05-22, IS: 2024-05-17, LV: 2024-04-08, LT: 2024-05-16, PT: 2024-04-10, RO: 2024-04-10, PL: 2024-04-09, SK: 2024-04-08, HU: 2024-04-12, SE: 2024-04-09, AT: 2024-04-15, DE: 2024-04-15, DK: 2024-04-08, NL: 2024-04-10, CZ: 2024-04-10, FR: 2024-04-12, IT: 2024-04-11, BE: 2024-04-18, ES: 2024-04-08, EE: 2024-04-11, FI: 2024-04-08

Condition(s): Adults at high risk of cardiovascular events without prior MI or stroke.
Product: Placebo for AMG 145, EVOLOCUMAB

Primary endpoint: Time to CHD death, MI, or ischemic stroke, whichever occurs first, Time to CHD death, MI, ischemic stroke, or any ischemia-driven arterial revascularization, whichever occurs first
Endpoint(s): Time to MI, ischemic stroke, or any ischemia-driven arterial revascularization, Time to CHD death, MI, or any ischemia-driven arterial revascularization, Time to cardiovascular death, MI, or ischemic stroke, Time to CHD death or MI, Time to MI, Time to any ischemia-driven arterial revascularization, Time to CHD death, Time to cardiovasular death, Time to all cause of death, Time to ischemic stroke

Source: https://euclinicaltrials.eu/ctis-public/view/2023-503673-38-00